EU clinical trial 2023-505929-14-00: A randomized, double-blind, placebo-controlled extension study to assess the long-term safety and tolerability of ianalumab in patients with systemic lupus erythematosus (SIRIUS-SLE extension)
Protocol code: VAY736F12301E1
Sponsor: Novartis Pharma AG (Pharmaceutical company). Phase: Therapeutic confirmatory (Phase III). Countries: Romania (ongoing, recruiting), Poland (ongoing, recruiting), Hungary (ongoing, recruiting), Portugal (ongoing, recruiting), Italy (ongoing, recruiting), Slovakia (ongoing, recruiting), Germany (ongoing, recruiting), France (ongoing, recruiting), Spain (ongoing, recruiting), Czechia (ongoing, recruiting), Bulgaria (ongoing, recruiting).
Therapeutic area(s): Diseases [C] - Immune System Diseases [C20]
Gender: Female, Male. Age: 18-64 years, 65+ years. Enrolment: 141.
Status: Ongoing, recruiting. Start date (EU): 2024-05-21. Decision date: 2024-05-07. Results received: No. Last updated: 2026-07-16.
Decision dates by country: IT: 2024-05-09, RO: 2024-05-13, CZ: 2024-05-10, DE: 2024-05-08, ES: 2024-05-09, BG: 2024-11-07, PT: 2024-05-08, SK: 2024-05-07, PL: 2024-05-07, FR: 2024-05-13, HU: 2024-05-08

Condition(s): Systemic Lupus Erythematosus
Product: ENTECAVIR, TENOFOVIR ALAFENAMIDE, Placebo to VAY736 00mg/ 00 mL Solution for injection in pre-filled pen, VAY736, TENOFOVIR DISOPROXIL, Placebo to VAY736 00 mg/00 mL Solution for injection in pre-filled syringe, VAY736

Primary endpoint: Incidence of treatment-emergent AEs (TEAEs)/SAEs
Endpoint(s): Proportion of participants who achieved SRI-4 response up to Week 216, Change from baseline in SLICC/ACR Damage Index up to Week 216, Average daily dose of oral corticosteroids administered up to Week 216, Annualized BILAG moderate or severe flare rate up to Week 216, Ianalumab serum concentrations during treatment and follow-up after last dose, Incidence and titer of anti-ianalumab antibodies in serum (ADA assay) over time

Source: https://euclinicaltrials.eu/ctis-public/view/2023-505929-14-00